EU clinical trial 2023-504173-21-00: MyKid-study: efficacy and systemic side effects of intracameral Mydrane® injections in children undergoing cataract surgery.
Protocol code: EDGE1169
Sponsor: Antwerp University Hospital (Hospital/Clinic/Other health care facility). Phase: Therapeutic use (Phase IV). Countries: Belgium (ended).
Therapeutic area(s): Diseases [C] - Eye Diseases [C11]
Gender: Female, Male. Age: 0-17 years. Enrolment: 40.
Status: Ended. Start date (EU): 2023-07-01. End date (EU): 2025-09-17. Decision date: 2023-06-30. Results received: No. Last updated: 2023-11-28.

Condition(s): pediatric cataract
Product: Mydrane 0,2 mg/ml + 3,1 mg/ml + 10 mg/ml oplossing voor injectie

Primary endpoint: Sufficient pupillary dilatation to perform surgery without mechanical dilatation
Endpoint(s): Hart rate and blood pressure

Source: https://euclinicaltrials.eu/ctis-public/view/2023-504173-21-00